EU clinical trial 2024-512052-38-00: A randomized non-comparative open-label phase 1b/2 study of nadunolimab in combination with gemcitabine plus carboplatin in patients with advanced triple negative breast cancer “TRIFOUR study”
Protocol code: CAN04CLIN005
Sponsor: Cantargia AB (Pharmaceutical company). Phase: Phase I and Phase II (Integrated)- Other. Countries: Spain (ended).
Therapeutic area(s): Diseases [C] - Neoplasms [C04]
Gender: Female, Male. Age: 18-64 years, 65+ years. Enrolment: 117.
Status: Ended. Start date (EU): 2021-12-02. End date (EU): 2026-05-08. Decision date: 2024-04-10. Results received: No. Last updated: 2026-03-02.

Condition(s): Advanced triple negative breast cancer
Product: CAN04, CARBOPLATIN, GEMCITABINE

Primary endpoint: Phase Ib: To determine the incidence rate of Dose Limiting Toxicity (DLT) within the first Cycle of nadunolimab in combination with GC., Phase II: to evaluate the ORR, defined as the rate of Complete Response (CR) plus Partial Response (PR) according to RECIST version 1.1, out of the patients who receive at least one dose of treatment and have measurable disease. These results will be calibrated against the ORR in the control arm.

Source: https://euclinicaltrials.eu/ctis-public/view/2024-512052-38-00